EU clinical trial 2023-505149-20-00: SAFETY AND POTENTIAL EFFECT OF INNOVATIVE CELL-BASED THERAPY USING ADIPOSE-DERIVED STROMAL VASCULAR FRACTION IN PATIENTS WITH AUTOIMMUNE XEROSTOMIA (STUDY XEROCELL)
Protocol code: XEROCELL
Sponsor: Assistance Publique Hopitaux De Marseille (Hospital/Clinic/Other health care facility). Phase: Phase I and Phase II (Integrated)- Other. Countries: France (ongoing, recruiting).
Therapeutic area(s): Diseases [C] - Stomatognathic Diseases [C07]
Gender: Female, Male. Age: 18-64 years, 65+ years. Enrolment: 18.
Status: Ongoing, recruiting. Start date (EU): 2024-09-13. Decision date: 2023-11-07. Results received: No. Last updated: 2025-12-19.

Condition(s): AUTOIMMUNE XEROSTOMIA

Source: https://euclinicaltrials.eu/ctis-public/view/2023-505149-20-00